EU clinical trial 2024-512293-10-00: A randomized, double-blind, placebo-controlled, multicenter clinical trial to assess safety and effectiveness of Liposom in enhance and speed up response to antidepressant therapy with citalopram in elderly patients suffering from Major Depressive Disorder (MDD)
Protocol code: QQ05.16.02
Sponsor: Fidia Farmaceutici S.p.A. (Pharmaceutical company). Phase: Therapeutic use (Phase IV). Countries: Italy (ongoing, recruiting).
Therapeutic area(s): Psychiatry and Psychology [F] - Psychological Phenomena [F02]
Gender: Female, Male. Age: 65+ years. Enrolment: 150.
Status: Ongoing, recruiting. Start date (EU): 2018-12-10. Decision date: 2024-11-12. Results received: No. Last updated: 2025-12-23.

Condition(s): Major Depressive Disorder in elderly patients
Product: Citalopram Aurobindo 20 mg compresse rivestite con film., Placebo of Liposom Forte, LIPOSOM FORTE “28 mg/2 ml soluzione iniettabile”

Primary endpoint: Improvement of depressive symptoms will be evaluated at Visit 5 (day 30), as change from baseline, using the Hamilton Rating Scale for Depression (21-item HAM-D).
Endpoint(s): Improvement of depressive symptoms will be evaluated over the entire study as change from baseline using the HAM-D., Percentage of patients responders at V2, V3, V4 and V5. A patient with a ≥ 50% improvement in HAM-D score vs. baseline will be considered as a responder., Reduction of latency time will be evaluated at V2, V3, V4 and V5 using the HAM-D. Latency time will be defined as the time from baseline to response (a ≥ 50% improvement in HAM-D score vs. baseline)., Improvement of depressive symptoms will be evaluated as change from baseline using the Geriatric Depression Scale (GDS-15) at each visit, up to V8 (Day 90)., Clinical Global Impression will be evaluated as change from baseline using the CGI score at each visit, up to V8 (Day 90)., To assess the safety of study treatments by tracking the adverse events at each visit, up to V8 (Day 90), by ECG and vital signs measurements.

Source: https://euclinicaltrials.eu/ctis-public/view/2024-512293-10-00